EU clinical trial 2022-502835-21-00: A randomised, double-blind, placebo-controlled, parallel group trial evaluating safety, tolerability, pharmacodynamics and pharmacokinetics of BI 1291583 one tablet once daily over 12 weeks versus placebo in adult patients with cystic fibrosis bronchiectasis (ClairaflyTM)
Protocol code: 1397-0013
Sponsor: Boehringer Ingelheim International GmbH, Boehringer Ingelheim Espana S.A. (Pharmaceutical company). Phase: Therapeutic exploratory (Phase II). Countries: Belgium (ended), Spain (ended), France (ended), Italy (ended), Germany (ended), Netherlands (ended).
Therapeutic area(s): Diseases [C] - Respiratory Tract Diseases [C08]
Gender: Female, Male. Age: 18-64 years, 65+ years. Enrolment: 17.
Status: Ended. Start date (EU): 2024-02-23. End date (EU): 2024-10-03. End date: 2024-10-08. Decision date: 2023-11-13. Results received: Yes. Last updated: 2024-12-17.
Decision dates by country: ES: 2023-11-15, NL: 2023-11-20, BE: 2023-11-13, FR: 2024-02-07, IT: 2023-11-14, DE: 2023-11-13

Condition(s): cystic fibrosis bronchiectasis
Product: SALBUTAMOL SULFATE, Placebo tablet matching BI 1291583, BI 1291583 5 mg

Primary endpoint: Occurrence of TEAEs up to 16 weeks from first drug administration.
Endpoint(s): Relative change from baseline in neutrophil elastase (NE) activity in sputum at week 8 after first drug administration (8 weeks was chosen as timepoint for this secondary endpoint to synchronise with potential cycling antibiotic use), AUC over a dosing interval (AUCτ) for the first dose., Maximum concentration (Cmax) for the first dose., AUCτ at steady state (AUCτ,ss)., Cmax at steady state (Cmax,ss).

Source: https://euclinicaltrials.eu/ctis-public/view/2022-502835-21-00